EU clinical trial 2024-514829-36-00: CARLHA-2_AN OPEN LABEL, RANDOMIZED, PHASE III STUDY EVALUATING THE EFFICACY OF ACOMBINATION OF APALUTAMIDE WITH RADIOTHERAPY AND LHRH AGONIST IN HIGH-RISK POST-PROSTATECTOMY BIOCHEMICALLY RELAPSED PROSTATE CANCER PATIENTS
Sponsor: Unicancer (Hospital/Clinic/Other health care facility). Phase: Therapeutic confirmatory (Phase III). Countries: France (ongoing, recruitment ended).
Therapeutic area(s): Diseases [C] - Neoplasms [C04]
Gender: Male. Age: 18-64 years, 65+ years. Enrolment: 429.
Status: Ongoing, recruitment ended. Start date (EU): 2019-12-02. Decision date: 2024-07-31. Results received: No. Last updated: 2025-12-19.

Condition(s): High-risk biochemically-relapsed prostate adenocarcinoma following radical prostatectomy.
Product: JNJ-56021927

Primary endpoint: The primary endpoint is the 5-year-progression free survival (PFS) accordingly to PERCIST 1.0 and RECIST 1.1 criteria. PFS idefined as time from date of randomization to date of first evidence of loco-regional recurrences, or distant metastases, or death from any cause whichever occurs first, or date of last known follow-up alive without any such events. Evidence of loco-regional recurrences is evaluated on PET CT; Evidence of distant metastases is evaluated on PET CT
Endpoint(s): Cancer-specific overall survival is defined as the time from the date of randomization to the date of death related to prostate cancer or the date of last known follow-up alive., Overall survival (OS) will be assessed at 10 years. OS is defined as the time from the date of randomization to the date of death from any cause or the date of last known follow-up alive., Biochemical relapse-free survival will be retrospectively defined by the interval between the date of randomization and the date of the first PSA elevation following the 6-months treatment in both arms (PSA ≥ 0.5 ng/mL confirmed by two consecutive PSA increases over a 2-months interval).If no biochemical relapse is observed, the PSA concentration will be measured every 6 months for 5 years and every year thereafter., Time to castration resistance is defined as the time from date of randomization to date of appearance of castration resistance defined in the EAU guidelines (Cornford Eur Urol 2017). Castration-resistant prostate cancer (CRPC) is defined as castrate serum testosterone <50 ng/dl or 1.7 nmol/l plus one of the following types of progression: - Biochemical progression - Radiologic progression:, Safety: Frequency, nature and severity of adverses events will be assessed according to the NCI CTCAE version 5.0 (see Appendix 4) Acute toxicity related to radiotherapy is defined as occurring during radiotherapy and up to 3 months after completion of radiotherapy. Late toxicity related to radiotherapy is defined as occurring later than 3 months after end of radiotherapy. The tolerance will be evaluated up until 10 years., Patient-reported outcomes: Quality of life will be assessed at baseline, at end of SRT, at end of treatment visit and at every follow up visit until disease progression by using: • EORTC QLQ-C30 questionnaire • EORTC QLQ-PR25 questionnaire • IIEF-5 questionnaire • IADL scale for patients ≥ 75 years old

Source: https://euclinicaltrials.eu/ctis-public/view/2024-514829-36-00